EU clinical trial 2024-510870-26-00: A study in healthy men to test how BI 1839100 is taken up and handled by the body
Protocol code: 1490-0006
Sponsor: Boehringer Ingelheim International GmbH (Pharmaceutical company). Phase: Human Pharmacology (Phase I)- Other. Countries: Netherlands (ended).
Therapeutic area(s): Not possible to specify
Gender: Male. Age: 18-64 years. Enrolment: 16.
Status: Ended. Start date (EU): 2024-09-24. End date (EU): 2025-09-02. Decision date: 2024-09-11. Results received: No. Last updated: 2024-09-11.

Condition(s): Healthy volunteer trial

Source: https://euclinicaltrials.eu/ctis-public/view/2024-510870-26-00